EU clinical trial 2023-506494-35-00: A Therapeutic Non-Inferiority, Randomized, Observer-blind, Active-reference, Two-arm, Parallel Group, Multi-center Clinical Trial for Comparing the Efficacy and Tolerability of a Generic Fixed Combination of Brinzolamide 10mg/ml + Timolol 5mg/ml Eye Drops versus Azarga® 10mg/ml + 5mg/ml Eye Drops in the Treatment of Intraocular Pressure in Patients with Open Angle Glaucoma or Ocular Hypertension
Protocol code: BECRO/OV/BRINZOTIM
Sponsor: OmniVision GmbH (Pharmaceutical company). Phase: Therapeutic confirmatory (Phase III). Countries: Greece (ended).
Therapeutic area(s): Diseases [C] - Eye Diseases [C11]
Gender: Female, Male. Age: 18-64 years, 65+ years. Enrolment: 234.
Status: Ended. Start date (EU): 2024-07-15. End date (EU): 2025-05-21. Decision date: 2024-05-20. Results received: No. Last updated: 2025-01-28.

Condition(s): Ocular Hypertension, Glaucoma
Product: AZARGA 10 mg/mL + 5 mg/mL eye drops, suspension, Brinzolamide-Timolol

Primary endpoint: The primary efficacy endpoint will be the difference between Test and Reference products in mean diurnal IOP change from baseline to week 12 visit after adjusting for baseline measurement (week 0)
Endpoint(s): Difference between Test and Reference products in mean diurnal IOP change from baseline to week 2 visit after adjusting for baseline measurement (week 0), Difference between Test and Reference products in mean diurnal IOP change from baseline to week 6 visit after adjusting for baseline measurement (week 0), Frequency of study drugs’ related adverse events

Source: https://euclinicaltrials.eu/ctis-public/view/2023-506494-35-00